EU clinical trial 2023-510440-20-00: Impact of oxygen therapy in exertion in physical activity of patients with fibrotic intertitial lung disease with exertional hypoxemia (AFOX study)
Protocol code: AFOX
Sponsor: Consorci Mar Parc De Salut De Barcelona (Hospital/Clinic/Other health care facility). Phase: Phase III and phase IV (Integrated). Countries: Spain (authorised, recruiting).
Therapeutic area(s): Diseases [C] - Respiratory Tract Diseases [C08]
Gender: Female, Male. Age: 65+ years. Enrolment: 36.
Status: Authorised, recruiting. Start date (EU): 2026-06-05. Decision date: 2024-05-24. Results received: No. Last updated: 2024-05-24.

Condition(s): Fibrotic interstitial lung disease
Product: OXYGEN

Primary endpoint: Change in the number of steps per day comparing the control group and the intervention group.
Endpoint(s): Changes in dyspnea questionnaire (dyspnea-12), quality of life (K-BILD) and anxiety and depression (HADS) between control and intervention group, Evaluate hours per day of oxygen therapy compliance, Analytical changes in oxidative stress between contol and intervention group

Source: https://euclinicaltrials.eu/ctis-public/view/2023-510440-20-00